EU clinical trial 2023-504624-25-00: A Biomarker-Directed Phase 2 Platform Study in Patients with Advanced Non-Small Cell Lung Cancer whose Disease has Progressed on First-Line Osimertinib Therapy (ORCHARD)
Protocol code: D6186C00001
Sponsor: AstraZeneca AB (Pharmaceutical company). Phase: Therapeutic exploratory (Phase II). Countries: Norway (ended), Netherlands (ongoing, recruitment ended), Spain (ended), Sweden (ongoing, recruitment ended), Italy (ended).
Therapeutic area(s): Diseases [C] - Neoplasms [C04]
Gender: Female, Male. Age: 18-64 years, 65+ years. Enrolment: 45.
Start date (EU): 2019-09-26. Decision date: 2024-08-14. Results received: No. Last updated: 2025-02-26.
Decision dates by country: IT: 2024-08-20, NL: 2024-08-14, NO: 2024-08-15, SE: 2024-08-14, ES: 2024-08-14

Condition(s): Advanced Non-Small Cell Lung Cancer
Product: CARBOPLATIN, Datopotamab deruxtecan, Inflectra 100 mg powder for concentrate for solution for infusion, ETOPOSIDE, CISPLATIN, Inflectra 100 mg powder for concentrate for solution for infusion, Inflectra 100 mg powder for concentrate for solution for infusion, Mycophenolate Mofetil Accord 250 mg capsules, Inflectra 100 mg powder for concentrate for solution for infusion, TAGRISSO 80 mg film-coated tablets, Inflectra 100 mg powder for concentrate for solution for infusion, IMFINZI 50 mg/mL concentrate for solution for infusion., TAGRISSO 40 mg film-coated tablets, Koselugo 25 mg hard capsules

Primary endpoint: To assess the efficacy of each treatment by evaluation of objective response rate - Endpoint based on Response Evaluation Criteria in Solid Tumours (RECIST 1.1) • Objective response rate (ORR)
Endpoint(s): To assess the efficacy of each treatment by evaluation of tumour response and overall survival Overall survival (OS) - Endpoint based on Response Evaluation Criteria in Solid Tumours (RECIST 1.1): • Progression-free survival (PFS) • Duration of response (DoR), To assess the pharmacokinetics (PK) of each treatment: plasma/serum concentrations will be measured., To assess the safety and tolerability of each treatment - • Adverse events/serious adverse events (AEs/SAEs): • Physical examinations • Laboratory findings • Vital signs • Electrocardiogram (ECG). • Left ventricular ejection fraction (LVEF)

Source: https://euclinicaltrials.eu/ctis-public/view/2023-504624-25-00